EU clinical trial 2025-521277-14-00: A Phase 2 Multicenter, Open-Label Study Evaluating the Efficacy and Safety of TYRA-300 in Participants with FGFR3 Altered Low Grade, Intermediate Risk Non-Muscle Invasive Bladder Cancer (SURF302)
Protocol code: TYR300-202
Sponsor: Tyra Biosciences Inc. (Pharmaceutical company). Phase: Therapeutic exploratory (Phase II). Countries: Italy (ongoing, recruiting), Spain (ongoing, recruiting), France (not authorised).
Therapeutic area(s): Diseases [C] - Neoplasms [C04]
Gender: Female, Male. Age: 18-64 years, 65+ years. Enrolment: 42.
Start date (EU): 2025-12-09. Decision date: 2025-10-08. Results received: No. Last updated: 2026-06-26.
Decision dates by country: FR: 2025-10-15, IT: 2025-10-08, ES: 2025-10-16

Condition(s): Non-muscle invasive bladder cancer (NMIBC)

Primary endpoint: Complete response (CR) rate at 3 months
Endpoint(s): -Duration of response (responders only)., -Time to recurrence (responders only), -Recurrence-free survival rate at 12 months and 24 months (responders only), -Incidence and severity of adverse events, incidence of impact on study drug dosing, changes in clinical laboratory parameters, vital sign changes.

Source: https://euclinicaltrials.eu/ctis-public/view/2025-521277-14-00